EU clinical trial 2023-509237-39-00: A Randomized, Double-Blind, Placebo-Controlled, Multicenter, Phase 3, Pivotal Study With an Open-Label Extension Period to Evaluate the Efficacy and Safety of Rozanolixizumab in Adult Participants With Myelin Oligodendrocyte Glycoprotein (MOG) Antibody-Associated Disease (MOG-AD)
Protocol code: MOG001
Sponsor: UCB Biopharma (Pharmaceutical company). Phase: Therapeutic confirmatory (Phase III). Countries: Spain (ongoing, recruitment ended), Belgium (ended), Portugal (ongoing, recruitment ended), Czechia (ongoing, recruitment ended), Sweden (ongoing, recruitment ended), France (ongoing, recruitment ended), Germany (ongoing, recruitment ended), Italy (ongoing, recruitment ended), Greece (ongoing, recruitment ended), Poland (ended).
Therapeutic area(s): Diseases [C] - Nervous System Diseases [C10]
Gender: Female, Male. Age: 18-64 years, 65+ years. Enrolment: 45.
Start date (EU): 2022-08-02. Decision date: 2024-08-22. Results received: No. Last updated: 2026-08-03.
Decision dates by country: BE: 2024-08-22, PL: 2025-06-23, GR: 2025-06-17, PT: 2024-08-22, IT: 2024-10-07, DE: 2024-08-30, CZ: 2024-08-23, FR: 2024-08-23, ES: 2024-08-22, SE: 2024-08-22

Condition(s): Myelin oligodendrocyte glycoprotein antibody-associated disease (MOGAD)
Product: Rozanolixizumab, also known as UCB7665, Rystiggo 140 mg/ml solution for injection

Primary endpoint: For Part A: 1.Time from randomization to first independently centrally adjudicated relapse (TTFR) during the Double Blind (DB) Treatment Period, For Part B: 2. Incidence of treatment-emergent adverse events (TEAEs) during Open-Label Extension (OLE) Treatment Period 3. Incidence of treatment-emergent adverse events (TEAEs) leading to permanent withdrawal of investigational medicinal product (IMP) during OLE Treatment Period
Endpoint(s): For Part A 1. Change from Baseline in Low-Contrast Monocular Visual Acuity (Worst Affected Eye) measured by low-contrast Landolt C Broken Rings Chart at the End of Double-Blind/Early Withdrawal (EDB/EWD) Visit, Disability as assessed by Expanded Disability Status Scale (EDSS) scores at the end of the EDB/EWD Visit (with confirmation at 3 months), Number of MOGAD related inpatient hospitalizations during the DB Treatment Period, Incidence of treatment-emergent adverse events (TEAEs) during DB Treatment Period, For Part B 5. Independently centrally adjudicated annualized relapse rate (ARR) during the DB and OLE Treatment Period

Source: https://euclinicaltrials.eu/ctis-public/view/2023-509237-39-00